EU clinical trial 2023-508637-14-00: Multicentric trial on the use of combined therapy of Thiamine and biotine in patients with Huntington´s disease.
Protocol code: HUNTIAM
Sponsor: Fundacion Publica Andaluza Para La Gestion De La Investigacion En Salud De Sevilla (Laboratory/Research/Testing facility). Phase: Phase I and Phase II (Integrated)- Other. Countries: Spain (ongoing, recruiting).
Therapeutic area(s): Diseases [C] - Nervous System Diseases [C10]
Gender: Female, Male. Age: 18-64 years, 65+ years. Enrolment: 24.
Status: Ongoing, recruiting. Start date (EU): 2024-06-06. Decision date: 2024-06-06. Results received: No. Last updated: 2026-03-17.

Condition(s): Huntington´s disease.
Product: THIAMINE

Primary endpoint: Periodic clinical examination and anamnesis directed by a neurologist during in-person and remote visits., The collection of adverse effects during the interviews of the in-person visits to assess tolerability., Analytical monitoring with hematological and biochemical control (liver and kidney function) during the dose escalation period, with this periodic control subsequently every 3 months.
Endpoint(s): Determination of thiamine levels (free, TMP and TTP) in CSF and blood of patients at the beginning of the study and after its completion., Comparison of thiamine levels (free, TMP and TTP) between the start and end of the study in CSF and blood of HD patients., Measurement of NfL (neurofilament light chain protein) levels in CSF., The score obtained in the motor and TFC (Total Functional Capacity) section of the UHDRS (Unified Huntington's Disease Rating Scale) (Annex III)., Quantitative motor assessment, Q-motor: is based on three-dimensional position sensors and pre-calibrated force translators (digitometers, among others) for standardized movement registration. This measurement will be carried out on patients at the pre-selection visit, randomization (baseline) and the quarterly in-person visits., Score on the quality of life scale (SF-36) (Annex IV)., Variation of the patient and examiner clinical global impression scale (CGI-SyC) (Annex V)., Measurement of the change in the volume of the caudate nucleus, white matter and cortical thinning, comparing these values with those described in prospective registries of patients with HD.

Source: https://euclinicaltrials.eu/ctis-public/view/2023-508637-14-00